EU clinical trial 2023-505989-29-00: A Phase 3, Open-label, Multicenter, Randomized Study of Tarlatamab in Combination with Durvalumab vs Durvalumab Alone in Subjects with Extensive Stage Small Cell Lung Cancer Following Platinum, Etoposide and Durvalumab (DeLLphi 305)
Protocol code: 20200041
Sponsor: Amgen Inc. (Pharmaceutical company). Phase: Therapeutic confirmatory (Phase III). Countries: Bulgaria (ended), Italy (ongoing, recruitment ended), Poland (ongoing, recruitment ended), Spain (ongoing, recruitment ended), Belgium (ongoing, recruitment ended), Greece (ongoing, recruitment ended), Hungary (ongoing, recruitment ended), Czechia (ongoing, recruitment ended), Denmark (ongoing, recruitment ended), France (ongoing, recruitment ended), Germany (ongoing, recruitment ended), Netherlands (ongoing, recruitment ended), Portugal (ongoing, recruitment ended), Romania (ongoing, recruitment ended), Austria (ended), Ireland (ended).
Therapeutic area(s): Diseases [C] - Neoplasms [C04]
Gender: Female, Male. Age: 18-64 years, 65+ years. Enrolment: 318.
Start date (EU): 2024-11-21. Decision date: 2024-06-04. Results received: No. Last updated: 2026-08-07.
Decision dates by country: IE: 2024-06-07, BG: 2024-06-10, AT: 2024-06-04, DK: 2024-06-04, PT: 2024-06-04, BE: 2024-06-06, CZ: 2024-06-07, FR: 2024-06-04, DE: 2024-06-06, GR: 2024-06-07, HU: 2024-06-05, IT: 2024-06-06, RO: 2024-06-06, ES: 2024-06-05, NL: 2024-06-10, PL: 2024-06-10

Condition(s): Extensive stage small cell lung cancer (ES-SCLC)
Product: CISPLATIN, Tarlatamab, DURVALUMAB, VASOPRESSIN (ARGIPRESSIN), Tarlatamab, PREDNISOLONE, SILTUXIMAB, TOCILIZUMAB, ELECTROLYTES, ETOPOSIDE, INFLIXIMAB, MYCOPHENOLATE MOFETIL, DEXAMETHASONE, CARBOPLATIN, PARACETAMOL

Primary endpoint: OS
Endpoint(s): PFS, Incidence of treatment emergent adverse events after randomization, PFS rate at 6 months 1 year and 2 years from randomization OS rate at 6 months 1 year 2 years, and 3 years from randomization TTP, Serum concentrations of tarlatamab, Change from baseline up to week 13 and week 25 in disease symptoms of Cough Chest Pain and Dyspnea ", Incidence of anti-tarlatamab antibody formation, OR, DC, DoR., Time to first deterioration (TTD) for Physical function Global health status/Quality of life

Source: https://euclinicaltrials.eu/ctis-public/view/2023-505989-29-00